EU clinical trial 2023-506668-15-00: A Phase 3, Multicenter, Randomized, Open Label Study of Etentamig Compared With Standard Available Therapy in Subjects With Relapsed or Refractory Multiple Myeloma (3L+ RRMM Monotherapy Study)
Protocol code: M22-574
Sponsor: AbbVie Deutschland GmbH & Co. KG (Pharmaceutical company). Phase: Therapeutic confirmatory (Phase III). Countries: Hungary (ongoing, recruitment ended), Germany (ongoing, recruitment ended), Spain (ongoing, recruitment ended), France (ongoing, recruitment ended), Greece (ongoing, recruitment ended), Czechia (ongoing, recruitment ended), Poland (ongoing, recruitment ended), Portugal (ongoing, recruitment ended), Austria (ongoing, recruitment ended), Denmark (ongoing, recruitment ended), Italy (ongoing, recruitment ended), Belgium (ongoing, recruitment ended), Sweden (ongoing, recruitment ended).
Therapeutic area(s): Diseases [C] - Neoplasms [C04]
Gender: Female, Male. Age: 18-64 years, 65+ years. Enrolment: 163.
Status: Ongoing, recruitment ended. Start date (EU): 2024-06-17. Decision date: 2024-05-24. Results received: No. Last updated: 2026-06-24.
Decision dates by country: CZ: 2024-05-27, AT: 2024-05-29, FR: 2024-05-27, DE: 2024-05-29, PL: 2024-05-28, SE: 2024-05-29, IT: 2024-05-29, HU: 2024-05-28, ES: 2024-05-27, PT: 2024-05-28, BE: 2024-05-24, GR: 2024-05-29, DK: 2024-05-24

Condition(s): Relapsed or Refractory Multiple Myeloma (RRMM)
Product: POMALIDOMIDE, BORTEZOMIB, POMALIDOMIDE, Etentamig, DIPHENHYDRAMINE, SELINEXOR, BORTEZOMIB, ELOTUZUMAB, DIPHENHYDRAMINE, CARFILZOMIB, POMALIDOMIDE, DEXAMETHASONE, PARACETAMOL, POMALIDOMIDE, PARACETAMOL, DEXAMETHASONE

Primary endpoint: Progression Free Survival (PFS) with Progressive Disease (PD) assessed according to the IMWG (2016) response criteria, per IRC assessment, Overall Response Rate (ORR) per IMWG (2016) response criteria (defined as PR + VGPR + CR + sCR) per IRC assessment
Endpoint(s): Overall Survival (OS), Rate of ≥VGPR per IRC assessment, Rate of ≥CR per IRC assessment, Rate of MRD negativity with ≥CR, defined as achievement of CR or better by IMWG (2016) response criteria (per IRC assessment) and MRD negative status as assessed by NGS Adaptive Clonoseq at 10- 5 threshold, Change from baseline at 6 months in disease symptoms as measured by the disease symptoms domain of the EORTC QLQ-MY20, Change from baseline at 6 months in physical functioning as measured by the physical functioning domain of the EORTC QLQ-C30, Time to response (TTR) per IRC assessment, Duration of response (DoR) per IRC assessment, Time to Disease Progression (TTP) per IRC assessment, Time to Next Therapy (TTNT), Event free survival (EFS), Patient Reported Outcomes (PROs): Change from baseline in the score of remaining scales and items of the EORTC QLQ-C30 and EORTC QLQ-MY20, PROMIS Fatigue SF 7a, EQ-5D-5L, PGIS; scores/frequencies of PGIS, PGIC and select items of the PRO-CTCAE, Skeletal-related event (SREs), defined as presence of any of the following events: - spinal cord compression; - pathologic fracture; - surgery to bone; - radiation to bone

Source: https://euclinicaltrials.eu/ctis-public/view/2023-506668-15-00